EU clinical trial 2025-524939-39-02: The Danish Anorexia Nervosa Psilocybin RCT (DANP-RCT). A Randomised, Active-Placebo-Controlled, Triple-blind, Superiority Study of Psilocybin-Assisted Acceptance and Commitment Therapy (ACT) in the Treatment of Treatment-resistant Anorexia Nervosa.
Sponsor: Slagelse Hospital (Hospital/Clinic/Other health care facility). Phase: Therapeutic exploratory (Phase II). Countries: Denmark (authorised, recruitment pending).
Therapeutic area(s): Psychiatry and Psychology [F] - Mental Disorders [F03]
Gender: Female. Age: 18-64 years. Enrolment: 62.
Status: Authorised, recruitment pending. Decision date: 2026-08-01. Results received: No. Last updated: 2026-08-01.

Condition(s): Anorexia nervosa
Product: PEX010

Primary endpoint: Baseline plus 10 weeks
Endpoint(s): Baseline plus 22 weeks

Source: https://euclinicaltrials.eu/ctis-public/view/2025-524939-39-02